EU clinical trial 2024-516188-10-00: Antiplatelet Secondary Prevention International Randomised study after INtracerebral haemorrhaGe - SM
Sponsor: University Of Edinburgh (Educational Institution). Phase: Therapeutic use (Phase IV). Countries: Netherlands (ongoing, recruiting), Belgium (authorised, recruitment pending).
Therapeutic area(s): Diseases [C] - Nervous System Diseases [C10]; Diseases [C] - Cardiovascular Diseases [C14]
Gender: Female, Male. Age: 18-64 years, 65+ years. Enrolment: 596.
Start date (EU): 2025-10-07. Decision date: 2025-05-07. Results received: No. Last updated: 2026-05-07.
Decision dates by country: BE: 2025-11-17, NL: 2025-05-07

Condition(s): Intracerebral haemorrhage
Product: Acetylsalicylzuur Aurobindo cardio 80 mg, tabletten., Clopidogrel Accord 75 mg filmomhulde tabletten

Primary endpoint: The first occurrence of any MACE, defined as hospitalisation due to stroke or myocardial infarction, or cardiovascular death
Endpoint(s): Major ischaemic events leading to hospitalisation or death (i.e. ischaemic stroke, myocardial infarction, pulmonary embolism, or peripheral arterial occlusion causing critical limb ischaemia or mesenteric ischaemia), Major haemorrhage leading to hospitalisation or death (i.e. symptomatic bleeding from the gastrointestinal tract, lungs, uterus, urinary tract, or in critical area or organ defined for non-surgical patients by the International Society of Thrombosis and Haemostasis: intracranial [exclusively extradural, subdural, or intraventricular], intraspinal, intraocular, retroperitoneal, intra-articular, pericardial, intramuscular with compartment syndrome, or another organ), Non-cardiovascular death, Non-hospitalized major adverse cardiovascular or cerebrovascular events (MACE); defined as MACE for which a patient was required to be seen in the emergency room but did not require a hospital-admission (ischaemic stroke, haemorrhagic stroke, stroke of unknown pathological type, or myocardial infarction), Hospitalisation due to stroke (ischaemic stroke, ICH, spontaneous subarachnoid haemorrhage, or stroke of unknown pathological type), Hospitalisation due to myocardial infarction, Cardiovascular death, due to any vascular cause, pulmonary embolism, haemorrhage, sudden death, or an unknown cause

Source: https://euclinicaltrials.eu/ctis-public/view/2024-516188-10-00